EU clinical trial 2023-508096-36-00: A Phase 3, multinational, multicenter, randomized, double-blind, placebo-controlled, parallel group 52-week extension study to evaluate the treatment response and safety of two amlitelimab dose regimens administered by subcutaneous injection in participants aged 12 years and older with moderate-to-severe atopic dermatitis
Protocol code: EFC17600
Sponsor: Sanofi-Aventis Recherche & Developpement (Pharmaceutical company). Phase: Therapeutic confirmatory (Phase III). Countries: Sweden (ended), Spain (ongoing, recruitment ended), Germany (ongoing, recruitment ended), Greece (ongoing, recruitment ended), Denmark (ongoing, recruitment ended), Poland (ongoing, recruitment ended), Bulgaria (ongoing, recruitment ended), Czechia (ongoing, recruitment ended), Italy (ongoing, recruitment ended), Portugal (ongoing, recruitment ended), France (ongoing, recruitment ended).
Therapeutic area(s): Diseases [C] - Skin and Connective Tissue Diseases [C17]
Gender: Female, Male. Age: 0-17 years, 18-64 years, 65+ years. Enrolment: 288.
Start date (EU): 2024-10-30. Decision date: 2024-07-02. Results received: No. Last updated: 2026-08-05.
Decision dates by country: IT: 2024-07-02, SE: 2024-07-05, DE: 2024-07-02, ES: 2024-07-08, GR: 2024-07-04, DK: 2024-07-08, PL: 2024-07-05, FR: 2024-07-08, PT: 2024-07-03, BG: 2024-07-05, CZ: 2024-07-03

Condition(s): atopic dermatitis
Product: Amlitelimab, TACROLIMUS, Amlitelimab, PIMECROLIMUS, Placebo

Primary endpoint: 1-{US and US countries} Proportion of participants who are responders AND maintained vIGA-AD ≤2 without experiencing relapse among participants who were responders at baseline of ESTUARY., 2-{EU & EU countries} Proportion of participants who maintain treatment response in ESTUARY without experiencing relapse.
Endpoint(s): 1-Proportion of participants who continue to be EASI-75^ among the participants who met EASI-75^ at baseline of ESTUARY. The symbol ^ represents "based on parent study baseline”., 2-Proportion of participants who continue to be vIGA-AD 0 or 1 among participants who met vIGA-AD 0 or 1 at baseline of ESTUARY, 3-Proportion of participants who continue to be vIGA-AD 0 or 1 with presence of only barely perceptible erythema (no induration/papulation, no lichenification, no oozing or crusting) among the participants who are vIGA-AD 0 or 1 with presence of only barely perceptible erythema (no induration/papulation, no lichenification, no oozing or crusting) at baseline of ESTUARY, 4-Proportion of participants who maintained weekly average of daily PP-NRS reduction of ≥4^ among the participants with weekly average of daily PP-NRS reduction of ≥ 4^ at baseline of ESTUARY., 5-Proportion of participants who maintain treatment response without experiencing relapse, 6-Percent change in EASI from parent study baseline, 7-Proportion of participants who maintained EASI-75^ without experiencing relapse among the participants who met EASI-75^ at baseline of ESTUARY, 8-Proportion of participants with EASI-75^, 9-Proportion of participants who continue to be EASI-90^ among the participants who met EASI-90^ at baseline of ESTUARY, 10-Proportion of participants with EASI-90^, 11-Time to the first event of vIGA-AD ≥3 or loss of EASI-75^ among the participants who were vIGA-AD 0 or EASI-75^ at baseline of ESTUARY, 12-Proportion of participants with vIGA-AD 0 or 1, 13-Proportion of participants who are vIGA-AD 0 or 1 with presence of only barely perceptible erythema (no induration/papulation, no lichenification, no oozing or crusting), 14-EU countries:Time to first event of vIGA-AD ≥3 or loss of EASI^75 among those participants who were vIGA-AD 0 or 1 at baseline of ESTUARY, 15-EU countries: Time to first event of vIGA-AD ≥3or loss of EASI^75 among those participants who were vIGA-AD 0 at baseline of ESTUARY, 16-Proportion of participants with weekly average of daily PP-NRS reduction of ≥4^, 17-Proportion of participants who maintain PP-NRS ≤4 among participants who were PP-NRS ≤4 at baseline of ESTUARY, 18-EU countries: Proportion of participants who maintained reduction in POEM ≥4^ among the participants with reduction in POEM ≥4^ at baseline of ESTUARY, 19-EU countries: Proportion of participants with a reduction in CDLQI ≥6^ among participants aged ≥12 to <16 years old and with reduction in CDLQI ≥6^ at baseline of ESTUARY, 20-EU countries: Proportion of participants with reduction in DLQI ≥4^ among the participants aged ≥16 years old and with reduction in DLQI ≥4^ at baseline of ESTUARY, 21-Percentage of participants who experienced Treatment-Emergent Adverse Events (TEAEs), Treatment-Emergent Serious Adverse Events (TESAEs) and/or Treatment-Emergent Adverse Events of Special Interest (AESI), 22-Pharmacokinetic serum amlitelimab concentrations, 23-Incidence of antidrug antibodies (ADAs) of amlitelimab, 24A-Pharmacokinetic: maximum plasma concentration (Cmax), 24B-Pharmacokinetic: AUC4W and AUC12W, 25-Proportion of participants who are EASI-75^ among participants who had EASI-75^ at baseline of ESTUARY and did not relapse by Week 12, 26-Time to first recapture of EASI-75^ among participants who had EASI-75^ at baseline of ESTUARY and subsequently relapsed, 27-Proportion of participants who recapture EASI-75^ by visit among the patients who had EASI-75^ at baseline of ESTUARY and subsequently relapsed, 28-Proportion of participants who are EASI 90^ AND who maintain EASI-75^ without experiencing relapse among participants who had EASI-90^ at baseline of ESTUARY, 29-Proportion of participants who are EASI 90^ without experiencing relapse among participants who had EASI-90^ at baseline of ESTUARY, 30-Proportion of participants who are EASI-90^ among participants who had EASI-90^ at baseline of ESTUARY and did not relapse by Week 12., 31-Proportion of participants who are vIGA-AD 0 or 1 AND who maintain vIGA-AD ≤2 without experiencing relapse among participants who had vIGA-AD 0 or 1 at baseline of ESTUARY, 32-Proportion of participants who maintain vIGA-AD response within 1 point of baseline without experiencing relapse among participants who had vIGA-AD 0 or 1 at baseline of ESTUARY, 33-Proportion of participants who maintain vIGA-AD 0 or 1 without experiencing relapse among participants who had vIGA-AD 0 or 1 at baseline of ESTUARY, 34-Proportion of participants who are vIGA-AD 0 or 1 without experiencing relapse among participants who had vIGA-AD 0 or 1 at baseline of ESTUARY, 35-Time to first recapture of vIGA-AD 0 or 1 among participants who had vIGA-AD 0 or 1 at baseline of ESTUARY and subsequently relapsed, 36-Proportion of participants who recapture vIGA-AD 0 or 1 among participants who had vIGA-AD 0 or 1 at baseline of ESTUARY and subsequently relapsed, 37-Proportion of participants who are vIGA-AD 0 or 1 among participants who had vIGA-AD 0 or 1 at baseline of ESTUARY and did not relapse by Week 12., 38-Proportion of participants who are vIGA-AD 0 or 1 with presence of only barely perceptible erythema (no induration/papulation, no lichenification, no oozing or crusting) AND who maintain vIGA-AD ≤2 without experiencing relapse among participants who had vIGA-AD 0 or 1 with presence of only barely perceptible erythema (no induration/papulation, no lichenification, no oozing or crusting) at baseline of ESTUARY, 39-Proportion of participants who are vIGA-AD 0 or 1 with presence of only barely perceptible erythema (no induration/papulation, no lichenification, no oozing or crusting) among participants who had vIGA-AD 0 or 1 with presence of only barely perceptible erythema (no induration/papulation, no lichenification, no oozing or crusting) at baseline of ESTUARY and did not relapse by Week 12, 40-Proportion of participants who maintain weekly average of daily PP-NRS reduction of ≥4^ without experiencing relapse among participants with weekly average of daily PP NRS reduction of ≥4^ at baseline of ESTUARY, 41-Proportion of participants who maintain PP NRS ≤4 without experiencing relapse among participants who had PP-NRS ≤4 at baseline of ESTUARY, 42-Proportion of participants who achieve PP-NRS reduction of ≥4, 43-Proportion of participants who achieve PP-NRS ≤4, 44-Duration of maintained response without relapse (remittive effect) (Time to last observed maintained response without relapse, 45-Percent change in Head & Neck EASI sub-score from the parent study baseline among participants with Head & Neck EASI sub-score >0 at baseline of the parent study, 46-Proportion of participants Head & Neck EASI sub-score EASI-75^ among participants with Head & Neck EASI sub-score >0 at baseline of the parent study, 47-Proportion of participants with Head & Neck EASI sub-score EASI-90^ among participants with Head & Neck EASI sub-score >0 at baseline of parent study

Source: https://euclinicaltrials.eu/ctis-public/view/2023-508096-36-00